EU clinical trial 2024-516169-35-00: SONOKID. A Phase I Trial Evaluating the Tolerability of Repeated Blood-Brain Barrier Disruption by Ultrasound Prior to Chemotherapy in the Treatment of Recurrent Supratentorial Primary Malignant Brain Tumors in Children.
Protocol code: D20181321
Sponsor: Assistance Publique Hopitaux De Paris (Hospital/Clinic/Other health care facility). Phase: Phase I and Phase II (Integrated)- First administration to humans. Countries: France (ongoing, recruiting).
Therapeutic area(s): Diseases [C] - Neoplasms [C04]
Gender: Female, Male. Age: 0-17 years. Enrolment: 24.
Status: Ongoing, recruiting. Start date (EU): 2023-02-06. Decision date: 2024-11-19. Results received: No. Last updated: 2026-04-22.

Condition(s): recurrent primary supratentorial malignant brain tumors in children
Product: SonoVue 8 microlitres/mL powder and solvent for dispersion for injection, CARBOPLATIN

Primary endpoint: Absence of Dose Limiting Toxicity (DLT) directly related to the ultrasound emission from the SonoCloud-9® device (3 emitters), assessed at each cycle
Endpoint(s): Evaluation of the grade of blood-brain barrier (BBB) opening by ultrasound as described by Carpentier et al., overall survival (OS) at 3 months and progression-free survival (PFS) at 6 months, Evaluation of the occurrence of allergic and/or cardiac complications., Evaluation of complications related to implantation or sonications (excluding ultrasound effects), evaluation of implantation and connection procedures, and assessment of the device's bioavailability and resistance., Evaluation of clinical and/or radiological complications beyond the first treatment cycle., Assessment of circulating tumor DNA, antigens or circulating tumor markers, and circulating tumor cells

Source: https://euclinicaltrials.eu/ctis-public/view/2024-516169-35-00